EU clinical trial 2023-509837-37-00: A feasibility trial investigating inductive Apalutamide therapy combined with radical prostatectomy in patients with locally advanced T4 high risk prostate cancer
Sponsor: Universitaet Des Saarlandes (Educational Institution). Phase: Therapeutic exploratory (Phase II). Countries: Germany (ended).
Therapeutic area(s): Diseases [C] - Neoplasms [C04]
Gender: Male. Age: 18-64 years, 65+ years. Enrolment: 20.
Status: Ended. Start date (EU): 2022-02-25. End date (EU): 2025-09-16. Decision date: 2024-01-18. Results received: No. Last updated: 2025-05-02.

Condition(s): Patients with locally advanced T4 high risk prostate cancer
Product: JNJ-56021927

Primary endpoint: The prim endpoint of this study is the proportion of pat. with operability - as assessed by MRI , transrectal ultrasound, and clinical examination (two experienced uro oncological surgeons) - upon inductive pre-prostatectomy treatment for a duration of up to 6 months. For patients who have not reached the PSA nadir after the 6-month period and are not considered as operable, the inductive therapy with apalutamide plus ADT can be expanded for a maximum of additiona
Endpoint(s): Proportion of patients with pT0 (pCR) in prostatectomy specimens (complete pathological response), Proportion of patients with negative margin specimen from prostatectomy according to the histology results after surgery, Proportion of patients with , Proportion of patients with post-prostatectomy complete biochemical remission (non-detectable serum PSA) 6 months after surgery without hormonal treatment, Proportion of patients with post-prostatectomy complications requiring surgical re-intervention (Clavien-Dindo IIIB complications, except for interventions aiming at hemostasis only) during the entire postprostatectomy period, Proportion of patients who achieve PSA nadir upon 6 months of inductive treatment, Proportion of patients who achieve PSA nadir, prior to surgery, Change from baseline in FACT-P scores (FACT-P Trial Outcome Index, FACT-G total score, and FACT-P total score) at different study visits., Proportion of patients with improvement in their FACT-P scores compared to baseline at different study visits., Change from baseline in EQ-5D-3L score at different study visits., Proportion of patients with improvement in the EQ-5D-3L score compared to baseline at different study visits., Proportion of patients with early (ie, before prostatectomy) PSA relapse from nadir, defined as an absolute PSA increase of more than 10% from the initial PSA value prior to therapy with two PSA rises after 2 consecutive measurements within 2 weeks., Proportion of patients with biochemical recurrence (BCR), defined as 2 consecutive PSA values >0.2 ng/mL and rising obtained at two consecutive scheduled study visits after prostatectomy., Time to biochemical recurrence (BCR) after prostatectomy, if possible., The change in ECOG performance status as well as the change in some hematologic parameters (hemoglobin, leukocytes, lymphocytes, neutrophils, platelets), and the change in levels of serum testosterone/hormones from baseline at different study visits, Time to treatment discontinuation., Safety and tolerability with regard to adverse events (AEs), abnormal laboratory results, and perioperative complications.

Source: https://euclinicaltrials.eu/ctis-public/view/2023-509837-37-00